EU clinical trial 2022-501259-10-00: A Phase 2, Open-Label, Multicenter, Basket Study Evaluating the Safety and Efficacy of Brexucabtagene Autoleucel in Adults with Rare B-cell Malignancies (ZUMA-25) – Substudy A – Relapsed/Refractory Waldenstrom Macroglobulinemia
Protocol code: KT-US-568-0138-A
Sponsor: Kite Pharma Inc. (Pharmaceutical company). Phase: Therapeutic exploratory (Phase II). Countries: Netherlands (ended), Spain (ended), Germany (ended), Sweden (ended), France (ended), Austria (ended), Italy (ended).
Therapeutic area(s): Diseases [C] - Neoplasms [C04]
Gender: Female, Male. Age: 18-64 years, 65+ years. Enrolment: 37.
Status: Ended. Start date (EU): 2023-04-14. End date (EU): 2023-06-21. Decision date: 2023-02-13. Results received: No. Last updated: 2023-05-26.
Decision dates by country: AT: 2023-02-20, DE: 2023-02-20, SE: 2023-02-14, NL: 2023-02-14, IT: 2023-02-14, ES: 2023-02-13, FR: 2023-05-03

Condition(s): Relapsed/Refractory Waldenstrom Macroglobulinemia (WM)
Product: MESNA, Tecartus 0.4 – 2 × 108 cells dispersion for infusion, IMBRUVICA 140 mg hard capsules, CYCLOPHOSPHAMIDE, METHYLPREDNISOLONE, DEXAMETHASONE, FLUDARABINE

Primary endpoint: The primary endpoint of ZUMA-25 as per the master protocol is response rates by central assessment as defined in each substudy. The primary end point of Substudy A (WM) is combined rate of CR and VGPR rate by central assessment defined as the proportion of subjects who achieve either CR or VGPR .
Endpoint(s): The secondary endpoints of ZUMA-25 as per the master protocol are: • CR rate by central assessment as defined in each substudy, • Duration of Response, • Overall Survival, • Progression-free survival, • Time to next treatment defined as the time from enrollment (for Full Analysis Set [FAS]) or brexucabtagene autoleucel infusion (for modified intention to treat [mITT]) to the initiation of subsequent anticancer therapy/treatment, • Time to first response from brexucabtagene autoleucel infusion to the first response as defined in the substudy, Substudy A (WM) specific secondary endpoints are: •ORR, defined as the proportion of subjects who achieve a best response of CR, VGPR, or partial response (PR), • Combined CR and VGPR rate by investigator assessment defined as the proportion of subjects who achieve either CR or VGPR, • Rate of VGPR and PR, separately

Source: https://euclinicaltrials.eu/ctis-public/view/2022-501259-10-00